EU clinical trial 2024-515414-40-00: Clinical and pathophysiological aspects of visualization of metabolic flux in the failing human heart using hyperpolarized [1-13C]-pyruvate cardiac magnetic resonance
Sponsor: Region Midtjylland (Hospital/Clinic/Other health care facility). Phase: Phase I and Phase II (Integrated)- Other. Countries: Denmark (ongoing, recruiting).
Therapeutic area(s): Diseases [C] - Cardiovascular Diseases [C14]; Analytical, Diagnostic and Therapeutic Techniques and Equipment [E] - Diagnosis [E01]
Gender: Female, Male. Age: 18-64 years, 65+ years. Enrolment: 30.
Status: Ongoing, recruiting. Start date (EU): 2019-12-01. Decision date: 2024-09-16. Results received: No. Last updated: 2026-02-13.

Condition(s): Heart failure
Product: Hyperpolarized [1-13C]pyruvate

Primary endpoint: Metabolic in vivo flux through the PDC in the myocardium in humans. Co-primary endpoints are: a) [13C]-bicarbonate/[1-13C]-pyruvate ratio, b) [1-13C]-lactate / [1-13C]-pyruvate ratio and [1-13C]-lactate / [1-13C]-bicarbonate ratio. The latter gives ratio indices of PDC-mediated pyruvate oxidation and lactate production via lactate dehydrogenase.

Source: https://euclinicaltrials.eu/ctis-public/view/2024-515414-40-00